EU clinical trial 2023-503436-40-00: A Phase 3, Multicenter, Double-blind, Randomized, Placebo-controlled, Parallel Group Study, Followed by an Active Treatment Phase to Evaluate the Efficacy and Safety of Apremilast in Children From 2 to Less Than 18 Years of Age With Active Oral Ulcers Associated With Behçet's Disease (BEAN)
Protocol code: 20190530
Sponsor: Amgen Inc. (Pharmaceutical company). Phase: Therapeutic confirmatory (Phase III). Countries: Italy (ongoing, recruitment ended), Greece (ongoing, recruitment ended), France (ongoing, recruitment ended), Spain (ongoing, recruiting).
Therapeutic area(s): Diseases [C] - Immune System Diseases [C20]
Gender: Female, Male. Age: 0-17 years. Enrolment: 32.
Start date (EU): 2024-11-11. Decision date: 2023-09-06. Results received: No. Last updated: 2026-07-13.
Decision dates by country: FR: 2023-09-08, IT: 2023-09-06, ES: 2023-09-07, GR: 2023-09-11

Condition(s): Behcet's disease, Oral ulcers associated with Behçet’s Disease
Product: Apremilast, Apremilast, Placebo for Film coated tablets (10mg,20mg and 30mg)and oral suspensiion(5mg/ml), Apremilast, Apremilast

Primary endpoint: Area under the curve (AUC) for the number of oral ulcers from baseline (week 0) to week 12
Endpoint(s): Number of oral ulcers from baseline (week 0) to week 12, Change in the pain of oral ulcers as measured by a visual analog scale (VAS) from baseline (week 0) to week 12 in subjects 5 years of age and older, Complete response rate for oral ulcers defined as the proportion of subjects who are oral ulcer free at week 12, Proportion of subjects at week 12 whose number of oral ulcers is reduced by greater than or equal to 50% from week 0, Complete response rate for genital ulcers defined as the proportion of subjects (with genital ulcers at week 0) who are genital ulcer free at week 12, Change from week 0 to week 12 in disease activity as measured by Behçet’s Disease Current Activity (BDCAF) scores, Proportion of subjects at week 12 who have new-onset (ie, absent at baseline) or recurrence (ie, with history) of Behçet’s-related manifestations (other than oral and genital ulcers), Change from baseline (week 0) to week 12 on the Short form Survey (SF-10), Type, frequency, severity, and relationship to investigational product of adverse events (including malignancies and serious/systemic infections), changes in clinical laboratory parameters, vital signs, and physical examination from signing of the informed consent/assent forms through week 52 and the 30 day posttreatment safety follow-up phase, Occurrence, severity, and frequency of suicide/suicide-related ideations and behaviors as assessed by the C-SSRS at select visits from week 0 through week 52 and the 30 day posttreatment safety follow-up visit, Tanner staging of sexual development assessment of sexual maturity at week 0 and week 52 (or early termination), Body weight, height, and BMI at week 0 (baseline) through week 52 and the 30 day posttreatment safety follow-up visit, Plasma concentrations of apremilast will be summarized by visit and dosing regimen from week 2 and to week 52, Taste and acceptability at week 0 and week 2, Proportion of subject who require protocol-prohibited medications due to worsening of BD from week 0 through week 12

Source: https://euclinicaltrials.eu/ctis-public/view/2023-503436-40-00